EU clinical trial 2023-509542-35-00: Study of MK-4830 as Monotherapy and in Combination With Pembrolizumab (MK-3475) in Participants With Advanced Solid Tumors (MK-4830-001)
Protocol code: MK-4830-001
Sponsor: Merck Sharp & Dohme LLC (Pharmaceutical company). Phase: Human Pharmacology (Phase I)- Other. Countries: Greece (ended), France (ended), Spain (ended), Poland (ended).
Therapeutic area(s): Diseases [C] - Neoplasms [C04]
Gender: Female, Male. Age: 18-64 years, 65+ years. Enrolment: 147.
Status: Ended. Start date (EU): 2020-03-02. End date (EU): 2025-09-23. End date: 2025-09-26. Decision date: 2024-03-18. Results received: No. Last updated: 2025-08-25.
Decision dates by country: FR: 2024-03-25, PL: 2024-03-25, GR: 2024-05-08, ES: 2024-03-18

Condition(s): Advanced Pancreatic cancer, Unresectable Glioblastoma and Variants, PD-1-exposed Advanced/Met HNSCC, Advanced/Met HNSCC, Advanced/Met NSCLC, Advance/Met RCC, Advanced/Met Gastric or GEJ adenocarcinoma, Ovarian Cancer. TNBC, Advanced Mesothelioma, Advanced Solid tumors(coformulation)

Source: https://euclinicaltrials.eu/ctis-public/view/2023-509542-35-00